EU clinical trial 2023-505584-36-00: A Phase 1 Study of JNJ-88549968, a T-cell Redirecting Antibody, for CALR-mutated Myeloproliferative Neoplasms
Protocol code: 88549968MPN1001
Sponsor: Janssen - Cilag International (Pharmaceutical company). Phase: Human Pharmacology (Phase I)- First administration to humans. Countries: France (ongoing, recruiting), Spain (ongoing, recruiting), Germany (ongoing, recruiting), Italy (ongoing, recruiting).
Therapeutic area(s): Diseases [C] - Neoplasms [C04]
Gender: Female, Male. Age: 18-64 years, 65+ years. Enrolment: 50.
Status: Ongoing, recruiting. Start date (EU): 2024-07-30. Decision date: 2024-02-16. Results received: No. Last updated: 2026-06-19.
Decision dates by country: ES: 2024-02-16, IT: 2025-07-07, DE: 2024-06-13, FR: 2024-03-11

Condition(s): CALR-mutated Myeloproliferative Neoplasms

Source: https://euclinicaltrials.eu/ctis-public/view/2023-505584-36-00